EU clinical trial 2023-509183-17-00: Molecular imaging with FAPI for diagnosing the CSM4 colorectal cancer subtype
Protocol code: U23-0607
Sponsor: Universitair Medisch Centrum Utrecht (Hospital/Clinic/Other health care facility). Phase: Human Pharmacology (Phase I)- Other. Countries: Netherlands (ongoing, recruiting).
Therapeutic area(s): Diseases [C] - Digestive System Diseases [C06]; Analytical, Diagnostic and Therapeutic Techniques and Equipment [E] - Diagnosis [E01]
Gender: Female, Male. Age: 18-64 years, 65+ years. Enrolment: 45.
Status: Ongoing, recruiting. Start date (EU): 2024-08-01. Decision date: 2024-03-27. Results received: No. Last updated: 2025-09-12.

Condition(s): Colorectal cancer, liver metastases

Source: https://euclinicaltrials.eu/ctis-public/view/2023-509183-17-00